EU clinical trial 2024-515470-26-00: NO EVIDENCE OF DISEASE ACTIVITY AFTER AUTOLOGOUS HAEMATOPOIETIC STEM CELL TRANSPLANTATION IN AGGRESSIVE MULTIPLE SCLEROSIS: THE NET-MS STUDY
Protocol code: NET-MS
Sponsor: Fondazione Italiana Sclerosi Multipla Ente Del Terzo Settore/et S (Patient organisation/association). Phase: Therapeutic exploratory (Phase II). Countries: Italy (ended).
Therapeutic area(s): Diseases [C] - Nervous System Diseases [C10]
Gender: Female, Male. Age: 18-64 years. Enrolment: 90.
Status: Ended. Start date (EU): 2024-10-31. End date (EU): 2026-06-30. Decision date: 2024-12-09. Results received: No. Last updated: 2025-11-17.

Condition(s): Relapsing Remitting Multiple Sclerosis
Product: Ocrevus 300 mg concentrate for solution for infusion, CYTARABINE, CARMUSTINE, CYCLOPHOSPHAMIDE, CYCLOPHOSPHAMIDE, Tysabri 300 mg concentrate for solution for infusion, CARMUSTINE, ETOPOSIDE, CARMUSTINE, UBLITUXIMAB, MELPHALAN FLUFENAMIDE, FILGRASTIM, FILGRASTIM, CYTARABINE, CYTARABINE, CYCLOPHOSPHAMIDE, RABBIT ANTI-HUMAN THYMOCYTE IMMUNOGLOBULIN, Kesimpta 20 mg solution for injection in pre-filled pen, ANTI-HUMAN T-LYMPHOCYTE IMMUNOGLOBULIN FROM RABBITS, CYTARABINE, LEMTRADA 12 mg concentrate for solution for infusion

Primary endpoint: The primary outcome is the occurrence of any evidence of multiple sclerosis disease activity (NEDA-3) over 36 months, analyzed as time-to-event [Time frame: from randomization up to 36 months post randomization]
Endpoint(s): The proportion of participants who experience a serious adverse event [Time frame: from randomization up to 36 months post randomization], The proportion of participants who experience a serious late adverse event [Time frame: from day 100 post AHSCT up to 36 months post randomization]., The annual relapse rate at 12, 24 and 36 months, The incidence of 6 months confirmed disability improvement as measured by the EDSS over 36 months, The prevalence of disability improvement over 36 months, The proportion of patients who have confirmed disability improvement, confirmed stable EDSS or confirmed disability progression at 12, 24 and 36 months, The incidence of 6 months confirmed progression on hand/arm function as measured by the 9HPT over 36 months, The incidence of 6 months confirmed progression on ambulation as measured by the T25FW test over 36 months, Number of new brain lesions at 12, 24 and 36 months, Number of gadolinium-enhancing brain lesions at 12, 24 and 36 months, Changes in whole brain volume at 12, 24 and 36 months, The proportion of patients with no evidence of disease activity including atrophy (NEDA-4) at 12, 24 and 36 months, Changes in MRI T2-weighted hyperintense lesion volume over 36 months, Changes in MRI T1-weighted hypointense lesion volume over 36 months, Changes in BICAMS z-scores at 12, 24 and 36 months, Changes in MSFC z-scores at 12, 24 and 36 months, Changes in serum neurofilament light chain concentration at 12, 24 and 36 months, Changes in the IgG/IgM index in the cerebrospinal fluid at 36 months, Presence of oligoclonal bands in the cerebrospinal fluid at 36 months, Changes in the 2.5 low contrast visual acuity at 12, 24 and 36 months, Changes in the peripheral retinal nerve fiber layer thickness assessed by optical coherence tomography at 12, 24 and 36 months, Changes in the retinal inner nuclear layer thickness assessed by optical coherence tomography at 12, 24 and 36 months, Changes in the Multiple Sclerosis Impact Scale at 12, 24 and 36 months, Changes in Multiple Sclerosis Walking Scale over at 12, 24 and 36 months, Changes in the Modified Fatigue Impact Scale at 12, 24 and 36 months, Changes in the WHO-QOL-Bref and the EuroQoL EQ-5D at 12, 24 and 36 months, All-cause mortality over 36 months, Proportion of participants who develop secondary autoimmune diseases over 36 months, Time to neutrophil engraftment among AHSCT recipients, Proportion of AHSCT recipients who experience primary or secondary graft failure, Percentage of female patients who experiences amenorrhoea during the study period, Percentage of female patients of child-bearing potential who maintains or resumes regular menstruation, Time to resumption of spontaneous menses after AHSCT and/or interruption of hormonal contraception, Variation in ovarian reserve parameters (anti-mullerian hormone levels and antral follicular count) over 36 months, Variation in sperm count, motility and morphology over 36 months, Percentage of pregnancy within 12 months of attempts among patients that will try to conceive after AHSCT [Time frame: from day 365 post AHSCT up to 36 months post randomization]., Number of new cervical spinal cord T2 lesions and of T1 gadolinium-enhancing lesions at 36 months.

Source: https://euclinicaltrials.eu/ctis-public/view/2024-515470-26-00